EU clinical trial 2025-521886-28-00: First-in-Human trial of DS9051b in participants with advanced solid tumors
Protocol code: DS9051-079
Sponsor: Daiichi Sankyo Inc. (Pharmaceutical company). Phase: Human Pharmacology (Phase I)- First administration to humans. Countries: France (authorised, recruiting).
Therapeutic area(s): Diseases [C] - Neoplasms [C04]
Gender: Female, Male. Age: 18-64 years, 65+ years. Enrolment: 15.
Status: Authorised, recruiting. Start date (EU): 2026-02-19. Decision date: 2025-12-03. Results received: No. Last updated: 2026-01-23.
Decision dates by country: FR: 2026-01-07

Condition(s): Advanced or Metastatic Adrenocortical Carcinoma (ACC), Metastatic Castration-resistant Prostate Cancer (CRPC)

Source: https://euclinicaltrials.eu/ctis-public/view/2025-521886-28-00